EU clinical trial 2023-503533-21-00: ALEPRO: abemaciclib and letrozole in estrogen receptor positive rare ovarian cancer
Protocol code: BGOG-OV70
Sponsor: UZ Leuven (Hospital/Clinic/Other health care facility). Phase: Therapeutic exploratory (Phase II). Countries: Belgium (ongoing, recruiting), France (ongoing, recruiting), Netherlands (ongoing, recruiting).
Therapeutic area(s): Diseases [C] - Neoplasms [C04]
Gender: Female. Age: 18-64 years, 65+ years. Enrolment: 90.
Status: Ongoing, recruiting. Start date (EU): 2023-11-21. Decision date: 2023-10-03. Results received: No. Last updated: 2026-07-06.
Decision dates by country: NL: 2024-04-04, BE: 2023-10-03, FR: 2024-03-19

Condition(s): Low-grade serous ovarian cancer, Adult-type granulosa cell tumor
Product: LETROZOLE, ABEMACICLIB

Primary endpoint: To determine the overall response rate (ORR) of the combination of abemaciclib and letrozole in the study population, as defined by RECIST v1.1.
Endpoint(s): Efficacy endpoints: duration of response (DOR), clinical benefit ratio (CBR), progression free survival (PFS), overall survival (OS), Safety endpoints, including but not limited to TEAEs, SAEs, hospitalizations, clinical laboratory tests, vital signs, and physical examinations, To evaluate participant-reported symptoms, function and global health status/QOL based on EORTC QLQ-C30 scales, To evaluate health status in the study population to inform decision modeling for health economic evaluation using the EQ-5D 5L index score, Exploratory endpoints: investigate potential biomarkers related to cyclin pathway and/or the pathogenesis of low-grade serous/endometrioid ovarian cancer and granulosa cell tumors.

Source: https://euclinicaltrials.eu/ctis-public/view/2023-503533-21-00